EU clinical trial 2024-510588-53-00: An Open-Label, Multinational, Multicenter, Phase 3b/4 Study of Trastuzumab Deruxtecan in Patients With or Without Baseline Brain Metastasis With Previously-Treated Advanced/Metastatic HER2-Positive Breast Cancer (DESTINY-Breast12)
Protocol code: D9673C00007
Sponsor: AstraZeneca AB (Pharmaceutical company). Phase: Phase III and phase IV (Integrated). Countries: Germany (ended), Poland (ongoing, recruitment ended), Spain (ended), Denmark (ended), Belgium (ongoing, recruitment ended), Ireland (ended), Portugal (ongoing, recruitment ended), Italy (ongoing, recruitment ended).
Therapeutic area(s): Diseases [C] - Neoplasms [C04]
Gender: Female, Male. Age: 18-64 years, 65+ years. Enrolment: 482.
Start date (EU): 2021-06-10. Decision date: 2024-09-18. Results received: No. Last updated: 2026-03-16.
Decision dates by country: IE: 2024-09-18, ES: 2024-09-23, DK: 2024-09-19, BE: 2024-09-19, IT: 2024-09-23, DE: 2024-09-19, PL: 2024-09-20, PT: 2024-09-18

Condition(s): Treatment of patients with HER2-positive breast cancer with or without brain metastasis
Product: DS-8201a

Primary endpoint: •Participants without BM at baseline (Cohort 1): ORR by RECIST 1.1 per ICR • Participants with BM at baseline (Cohort 2): PFS by RECIST 1.1 per ICR
Endpoint(s): • Both cohorts: - OS; - DoR (RECIST ICR); - Time to progression (RECIST ICR); - DoT on subsequent therapy lines; - PFS2. • Cohort 1 only: - Incidence of new symptomatic CNS metastasis during treatment. • In patients with isolated CNS progression, receive local therapy, and continue on protocol therapy: - Time to next progression (CNS or extracranial) or death; - Site (CNS vs extracranial vs both) of next progression., Participants with BM at baseline (Cohort 2): - ORR by RECIST 1.1 per ICR; - CNS PFS by CNS RECIST 1.1 per ICR; - Time to new CNS lesions; - CNS ORR by CNS RECIST 1.1 per ICR; - CNS DoR by CNS RECIST 1.1 per ICR, Changes in symptoms, functioning, and HRQoL as measured by • All patients: EORTC QLQ-C30, NANO scale, cognitive tests. • BM patients: MDASI brain tumor-specific items. • ILD/pneumonitis patients: SGRQ-I, Safety and tolerability will be evaluated in terms of AEs, vital signs, clinical laboratory results, and ECGs, rate of investigator-assessed ILD/pneumonitis, and rate of AEs among patients with baseline BM who are treated with concurrent high-dose steroid (total daily dose > 2 mg dexamethasone or equivalent)

Source: https://euclinicaltrials.eu/ctis-public/view/2024-510588-53-00